EU clinical trial 2025-520611-14-00: A Multicentric, Drug-Repositioning, Self Controlled Case Series (SCCS) Clinical Trial to Evaluate the Efficacy and Safety of Perampanel in Improving Behavioral Symptoms and Increasing the Quality of Life in Patients with White-Sutton syndrome (POGZ-Related Disorder)
Protocol code: 5MILLE_CT1
Sponsor: Istituto Di Ricovero E Cura A Carattere Scientifico Materno Infantile Burlo Garofolo (Hospital/Clinic/Other health care facility). Phase: Therapeutic exploratory (Phase II). Countries: Italy (authorised, recruitment pending).
Therapeutic area(s): Phenomena and Processes [G] - Genetic Phenomena [G05]
Gender: Female, Male. Age: 0-17 years, 18-64 years. Enrolment: 41.
Status: Authorised, recruitment pending. Decision date: 2025-02-03. Results received: No. Last updated: 2025-11-03.

Condition(s): White-Sutton syndrome (POGZ-Related Disorder)
Product: Fycompa 4 mg film-coated tablets, Fycompa 2 mg film-coated tablets

Primary endpoint: Evaluation of differences in total CBCL scores, administered before (at baseline) and at month 6, during Perampanel intake at minimum dosage
Endpoint(s): Evaluation of differences in scores of all neuropsychological scales administered before (at baseline) and during (at month 12 or 18) Perampanel intake. Recording of: - Medical history; - Clinical features; - Pharmacological history; - Physical examination; - Instrumental evaluation; - Neuropsychological assessment

Source: https://euclinicaltrials.eu/ctis-public/view/2025-520611-14-00